EU clinical trial 2024-512850-10-00: Adjuvant hepatic arterial infusion pump chemotherapy after resection of colorectal liver metastases in patients with a low clinical risk score – a randomized controlled trial
Sponsor: Erasmus Universitair Medisch Centrum Rotterdam (Erasmus MC) (Hospital/Clinic/Other health care facility). Phase: Therapeutic confirmatory (Phase III). Countries: Netherlands (authorised, recruitment pending).
Therapeutic area(s): Diseases [C] - Neoplasms [C04]; Analytical,Diagnostic,Therapeutic Techniques and Equipment [E]-Surgical Procedures, Operative [E04]
Gender: Female, Male. Age: 18-64 years, 65+ years. Enrolment: 230.
Status: Authorised, recruitment pending. Decision date: 2024-10-08. Results received: No. Last updated: 2024-10-08.

Condition(s): Resectable colorectal rectal metastases without extrahepatic disease

Primary endpoint: progression free survival (PFS)
Endpoint(s): Overall survival, Progression free survival in the liver, Postoperative complications, adverse events, Quality of life, Cost effectiveness, the accuracy of CT angiography to detect extrahepatic perfusion, pharmacokinetic profile of intra-arterial administration of floxuridine will, predictive biomarkers for the efficacy of HAIP chemotherapy

Source: https://euclinicaltrials.eu/ctis-public/view/2024-512850-10-00